EU clinical trial 2024-512467-31-00: "INDIGO-FAPI": Cutting Edge Imaging for Earlier Pancreatic Cancer Diagnosis: evaluation of Positron Emission Tomography (PET) with the Fibroblast Activation Protein Inhibitor (FAPI)
Sponsor: Institut Curie (Hospital/Clinic/Other health care facility). Phase: Phase I and Phase II (Integrated)- Other. Countries: France (ongoing, recruiting).
Therapeutic area(s): Diseases [C] - Neoplasms [C04]
Gender: Female, Male. Age: 18-64 years, 65+ years. Enrolment: 50.
Status: Ongoing, recruiting. Start date (EU): 2025-12-02. Decision date: 2024-10-18. Results received: No. Last updated: 2026-03-13.

Condition(s): Non-metastatic Pancreatic ductal adenocarcinoma
Product: 68Ga-FAPI-46

Primary endpoint: Time from diagnosis to disease progression, recurrence, or death (EFS: Event Free Survival). Progression or recurrence will be assessed by CT scans performed as part of routine care. The usual time interval between two CT scans is three months, but additional evaluations are possible at the physician’s discretion, e.g. triggered by clinical events.
Endpoint(s): FAPI positive volume, SUV of every target lesion, Time from surgery to disease recurrence or death (DFS: Disease Free Survival)., AEs and SAEs, considered by the investigator as related to 68Ga-FAPI-46 PET-CT, reported by rate and grade (NCI CTC-AEs v5.0)., Comparison of 68Ga-FAPI-46 PET/CT and other imaging modalities (CT, MRI and 18F-FDG PET/CT) performances for: - detection of metastases (using the total number of metastatic lesion) - For 18F-FDG PET/CT only, evaluation of the tumor burden (using the total FAP expression tumor volume/TFTV* and the total metabolic tumor volume/TMTV*, respectively). * TMTB is defined as the sum over all lesions of the metabolic tumor volume (MTV) multiplied by the SUVmean in that volume., Exploratory: Difference of SUVmax, FAP and metabolic volume burden defined above (for 68Ga-FAPI-46 PET/CT and 18F-FDG PET/CT respectively) before and after neoadjuvant/induction chemotherapy

Source: https://euclinicaltrials.eu/ctis-public/view/2024-512467-31-00